EU clinical trial 2023-507382-26-00: The ENERGY 3 Study: A Randomized, Controlled, Open-Label, Phase 3 Study to Evaluate the Efficacy and Safety of INZ-701 in Children with Ectonucleotide Pyrophosphatase/Phosphodiesterase 1 (ENPP1) Deficiency
Protocol code: INZ701-106
Sponsor: Inozyme Pharma Inc. (Pharmaceutical company). Phase: Therapeutic confirmatory (Phase III). Countries: France (ended), Spain (ended).
Therapeutic area(s): Diseases [C] - Congenital, Hereditary, and Neonatal Diseases and Abnormalities [C16]
Gender: Female, Male. Age: 0-17 years. Enrolment: 8.
Status: Ended. Start date (EU): 2024-05-24. End date (EU): 2026-06-01. Decision date: 2024-03-06. Results received: No. Last updated: 2026-03-30.
Decision dates by country: ES: 2024-03-06, FR: 2024-03-11

Condition(s): Ectonucleotide Pyrophosphatase/Phosphodiesterase 1 (ENPP1) Deficiency
Product: INZ-701

Primary endpoint: Change from Baseline in plasma PPi concentration through Week 52, RGI-C global score through Week 52
Endpoint(s): Change from Baseline in RSS total score through Week 52, Change from Baseline in growth Z-score (height/body length and weight) through Week 52, Measurement of INZ-701 serum concentration and enzyme activity, Please refer to the protocol for Tertiary and Safety endpoints

Source: https://euclinicaltrials.eu/ctis-public/view/2023-507382-26-00